EU clinical trial 2023-509576-42-00: A Phase III, Double-blind, Placebo controlled, Multi-center International Study of Neoadjuvant/Adjuvant Durvalumab for the Treatment of Patients with Resectable Stages II and III Non-small Cell Lung Cancer (AEGEAN).
Protocol code: D9106C00001
Sponsor: AstraZeneca AB (Pharmaceutical company). Phase: Therapeutic confirmatory (Phase III). Countries: Hungary (ongoing, recruitment ended), Poland (ongoing, recruitment ended), Austria (ongoing, recruitment ended), France (ongoing, recruitment ended), Netherlands (ongoing, recruitment ended), Italy (ongoing, recruitment ended), Spain (ongoing, recruitment ended), Belgium (ongoing, recruitment ended), Germany (ongoing, recruitment ended).
Therapeutic area(s): Diseases [C] - Neoplasms [C04]
Gender: Female, Male. Age: 18-64 years, 65+ years. Enrolment: 358.
Status: Ongoing, recruitment ended. Start date (EU): 2019-02-21. Decision date: 2024-08-14. Results received: No. Last updated: 2025-11-24.
Decision dates by country: BE: 2024-08-14, ES: 2024-08-14, NL: 2024-08-19, AT: 2024-08-22, PL: 2024-08-16, DE: 2024-08-16, FR: 2024-08-14, HU: 2024-08-14, IT: 2024-09-02

Condition(s): Patients with resectable Non-small Cell Lung Cancer (Stage IIA to IIIB; either squamous or non-squamous).
Product: PACLITAXEL, GEMCITABINE HYDROCHLORIDE, MYCOPHENOLATE MOFETIL, GEMCITABINE, CISPLATIN, INFLIXIMAB, CARBOPLATIN, PEMETREXED, PEMETREXED DISODIUM, IMFINZI 50 mg/mL concentrate for solution for infusion.

Primary endpoint: Event-free Survival (EFS) and pathological Complete Response (pCR) in modified intent-to-treat (mITT).
Endpoint(s): DFS in the modified resected population., mPR (≤10% viable tumour cells in lung primary tumour after complete evaluation in the resected lung cancer specimen)., OS., EFS, pCR, DFS, mPR, OS in the population with PD-L1 TC ≥1%., Change from baseline in Patient reported outcomes and time to deterioration., Concentration of durvalumab., Presence of ADAs for durvalumab.

Source: https://euclinicaltrials.eu/ctis-public/view/2023-509576-42-00